EU clinical trial 2023-506003-26-00: A Phase 1 Study of BMS-986453 in Participants with Relapsed and/or Refractory Multiple Myeloma
Protocol code: CA1190002
Sponsor: Celgene Corp. (Pharmaceutical company). Phase: Human Pharmacology (Phase I)- First administration to humans. Countries: Spain (ongoing, recruiting), France (ongoing, recruiting), Germany (ongoing, recruiting).
Therapeutic area(s): Diseases [C] - Neoplasms [C04]
Gender: Female, Male. Age: 18-64 years, 65+ years. Enrolment: 50.
Status: Ongoing, recruiting. Start date (EU): 2024-11-27. Decision date: 2024-11-19. Results received: No. Last updated: 2026-07-06.
Decision dates by country: FR: 2024-12-04, ES: 2024-11-26, DE: 2024-11-26

Condition(s): Relapsed and/or Refractory Multiple Myeloma

Source: https://euclinicaltrials.eu/ctis-public/view/2023-506003-26-00